EU clinical trial 2025-521606-18-00: A Phase 2, Open-Label, Randomized, Master Protocol Dose Optimization Study to Evaluate Safety and Efficacy of Multiple Treatment Combinations with Mirvetuximab Soravtansine in Subjects with Ovarian Cancer (FLORENZA)
Protocol code: M25-709
Sponsor: AbbVie Deutschland GmbH & Co. KG (Pharmaceutical company). Phase: Therapeutic exploratory (Phase II). Countries: Spain (ongoing, recruiting), Czechia (authorised, recruiting), France (ongoing, recruiting), Belgium (ongoing, recruiting), Denmark (ongoing, recruiting).
Therapeutic area(s): Diseases [C] - Neoplasms [C04]
Gender: Female. Age: 18-64 years, 65+ years. Enrolment: 150.
Start date (EU): 2026-01-29. Decision date: 2026-01-19. Results received: No. Last updated: 2026-07-10.
Decision dates by country: CZ: 2026-02-13, ES: 2026-01-23, BE: 2026-01-19, DK: 2026-01-20, FR: 2026-01-23

Condition(s): Ovarian Cancer
Product: CARBOPLATIN, Mirvetuximab Soravtansine, BEVACIZUMAB

Primary endpoint: Substudy 1 and 2 and 3: Number of Participants with TEAEs (any grade, Grade ≥ 3), Substudy 1 and 2 nad 3: Number of Participants with TEAEs leading to discontinuation, Substudy 1 and 2 and 3: Number of Participants with Ocular AEs (any grade, Grade ≥ 2), Substudy 1 and 2 and 3: Overall Response (OR) as assessed by the investigator per RECIST v1.1, Substudy 1: Progression free survival (PFS) as assessed by the investigator per RECIST v1.1
Endpoint(s): Substudy 1 and 2 and 3: CA-125 response per Gynecologic Cancer Intergroup (GCIG) Criteria, Substudy 1 and 2 and 3: Duration of Response (DOR) as assessed by the investigator per RECIST v1.1, Substudy 1 and 2 and 3: Number of Participants with Peripheral neuropathy AEs (any grade, Grade ≥ 2), Substudy 1 and 2 and 3: Number of Participants with Pneumonitis/ Interstitial Lung Disease (ILD) (any grade), Substudy 2 and 3: PFS as assessed by the investigator per RECIST v1.1

Source: https://euclinicaltrials.eu/ctis-public/view/2025-521606-18-00